EU clinical trial 2025-522082-29-00: A study to find a suitable dose of ASP5834 in adults with solid tumors
Protocol code: 5834-CL-1001
Sponsor: Astellas Pharma Inc. (Pharmaceutical company). Phase: Human Pharmacology (Phase I)- First administration to humans. Countries: Spain (ongoing, recruiting), France (ongoing, recruiting).
Therapeutic area(s): Diseases [C] - Neoplasms [C04]
Gender: Female, Male. Age: 18-64 years, 65+ years. Enrolment: 70.
Status: Ongoing, recruiting. Start date (EU): 2026-01-16. Decision date: 2025-11-28. Results received: No. Last updated: 2026-05-27.
Decision dates by country: ES: 2025-12-03, FR: 2025-11-28

Condition(s): Locally advanced (unresectable) or metastatic solid tumor malignancies who harbor a KRAS mutation (G12V, G12D, G12C, G12A, G12R or G13D mutation) or KRAS amplification

Source: https://euclinicaltrials.eu/ctis-public/view/2025-522082-29-00